EU clinical trial 2023-510194-34-00: A Phase 2, single arm, open label, multicenter study to assess minimal residual disease after isatuximab in combination with bortezomib and lenalidomide with minimal dexamethasone in patients with newly diagnosed multiple myeloma ineligible for autologous transplant.
Sponsor: Oslo University Hospital HF (Hospital/Clinic/Other health care facility). Phase: Therapeutic exploratory (Phase II). Countries: Norway (ongoing, recruitment ended), Denmark (ongoing, recruitment ended).
Therapeutic area(s): Diseases [C] - Immune System Diseases [C20]; Diseases [C] - Neoplasms [C04]
Gender: Female, Male. Age: 65+ years. Enrolment: 51.
Status: Ongoing, recruitment ended. Start date (EU): 2021-06-18. Decision date: 2024-10-09. Results received: No. Last updated: 2026-03-25.
Decision dates by country: DK: 2024-10-10, NO: 2024-10-09

Condition(s): Multiple myeloma
Product: ISATUXIMAB, LENALIDOMIDE, BORTEZOMIB, DEXAMETHASONE

Primary endpoint: The proportion of patients who achieve MRD negativity measured by NGF Euroflow during/or after first 18 Cycles of study treatment.
Endpoint(s): The proportion of patients who achieve PR or better after 2 cycles of IVRd followed by 6 cycles of IVR, followed by 10 cycles of IR., The PFS rate, The OS rate, The number of AEs and relevant laboratory parameters monitored at every visit (see SoA) from inclusion until end of study., The change in HRQL trajectories and steroid toxicity over time (day 22 – day 1) during IVRd (cycle 1 and 2) compared to IVR (cycle 4 and 5).

Source: https://euclinicaltrials.eu/ctis-public/view/2023-510194-34-00